EU clinical trial 2023-506585-31-00: A Phase 1 Study of JNJ-78278343, a T-Cell-Redirecting Agent Targeting Human Kallikrein 2 (KLK2), for Advanced Prostate Cancer
Protocol code: 78278343PCR1001
Sponsor: Janssen - Cilag International (Pharmaceutical company). Phase: Human Pharmacology (Phase I)- First administration to humans. Countries: Spain (ongoing, recruitment ended), France (ongoing, recruitment ended), Netherlands (ongoing, recruitment ended).
Therapeutic area(s): Diseases [C] - Neoplasms [C04]
Gender: Male. Age: 18-64 years, 65+ years. Enrolment: 103.
Status: Ongoing, recruitment ended. Start date (EU): 2021-07-09. Decision date: 2024-01-11. Results received: No. Last updated: 2026-06-02.
Decision dates by country: NL: 2024-01-11, FR: 2024-01-16, ES: 2024-01-12

Condition(s): Metastatic castration-resistant prostate cancer

Source: https://euclinicaltrials.eu/ctis-public/view/2023-506585-31-00